EU clinical trial 2023-508794-83-00: EBUL0. A 20-Week Multicentre, Open Study Assessing the Efficacy and Safety of Apremilast in Patients > 6 years of age with Epidermolysis bullosa simplex generalized
Sponsor: Centre Hospitalier Universitaire De Nice (Hospital/Clinic/Other health care facility). Phase: Therapeutic exploratory (Phase II). Countries: France (ongoing, recruiting).
Therapeutic area(s): Diseases [C] - Skin and Connective Tissue Diseases [C17]
Gender: Female, Male. Age: 0-17 years, 18-64 years, 65+ years. Enrolment: 20.
Status: Ongoing, recruiting. Start date (EU): 2025-01-10. Decision date: 2024-06-18. Results received: No. Last updated: 2026-07-29.
Decision dates by country: FR: 2024-09-23

Condition(s): Epidermolysis bullosa simplex
Product: Otezla 10mg, 20mg, 30 mg film-coated tablets, Otezla 10mg, 20mg, 30 mg film-coated tablets, Otezla 10mg, 20mg, 30 mg film-coated tablets, Otezla 30 mg film-coated tablets

Primary endpoint: The aim of this study is to assess the efficacy of apremilast in the treatment of patients with EBS-sev.
Endpoint(s): Safety and tolerability will be assessed through the description of the following specific events occurring during the treatment periods of the study plus 1 week to be conservative, Secondary efficacy and health outcomes measures:Severity, itch, pain, Duration of dressing, Quality of life, compliance, Validation of a new severity scale for EBS-sev patients

Source: https://euclinicaltrials.eu/ctis-public/view/2023-508794-83-00